EU clinical trial 2025-521257-17-00: DREPAMIR - A Phase 1/2 Open Label Cohort Comparative Study Evaluating the Efficacy and the safety of Gene Therapy of the Sickle Cell Disease by Transplantation of an Autologous CD34+ enriched cell fraction that contains autologous CD34+ cells transduced ex vivo by the bifunctional βAS3m/miR7m lentiviral vector expressing the βAS3m and a micro-RNA (miRNA) targeting specifically the endogenous βS-globin mRNA in Patients with Sickle Cell Disease (SCD)
Protocol code: APHP241664
Sponsor: Assistance Publique Hopitaux De Paris (Hospital/Clinic/Other health care facility). Phase: Phase I and Phase II (Integrated)- First administration to humans. Countries: France (ongoing, recruiting).
Therapeutic area(s): Diseases [C] - Hemic and Lymphatic Diseases [C15]
Gender: Female, Male. Age: 0-17 years, 18-64 years. Enrolment: 13.
Status: Ongoing, recruiting. Start date (EU): 2026-02-25. Decision date: 2026-01-16. Results received: No. Last updated: 2026-03-16.
Decision dates by country: FR: 2026-02-09

Condition(s): SCD severe patients
Product: Dream01, IMATINIB

Primary endpoint: Efficacy and safety after intravenous infusion of DREAM01 gene therapy with or without prior administration of Imatinib treatment.
Endpoint(s): Proportion of subjects with reduction in annualized rate of VOE at the time of analysis from baseline by at least 90% up to 24 months after DREAM01 infusion. The evaluation starts 60 days after the last RBC transfusion for post-transplant support or SCD disease management, Transfusion requirement and change in number of units of RBCs transfused for SCD-related indications over time, Percentage of HbAS3 and HbS over time, Vector copy number over time, Biologic parameters that reflect hemolysis and anemia over time (Total hemoglobin, Reticulocytes, lactate dehydrogenase LDH, circulating erythroblasts, haptoglobin, free plasmatic heme, no conjugated bilirubin, erythropoietin EPO), Biologic, functional and radiologic parameters reflecting organ function that may be affected by the disease or conditioning (evaluation of cerebral, ophthalmic, cardiac, renal, liver, pulmonary, bone, muscular), Evaluation of iron overload (ferritin, liver and cardiac MRI) and specific treatment (chelator, phlebotomy), Fertility evaluation: to be adapted according to sex: spermogram, hormone assays (estradiol, LH, FSH, testosterone, etc.), AMH, pelvic ultrasound for follicular count, Physical ability and capacity (6-minute walk-test, vertical jump test, physical ability questionnaire, cardiopulmonary exercise test), Quality of life Evaluation: SF-36 (Short Form-36 Health Survey), FACIT-Fatigue (Functional Assessment of Chronic Illness Therapy-Fatigue Scale), PROMIS (Patient-Reported Outcomes Measurement Information System) or PedsQL (Pediatric Quality of Life Inventory) Generic Core Scales

Source: https://euclinicaltrials.eu/ctis-public/view/2025-521257-17-00